EU clinical trial 2024-514688-24-00: Phase-I/II trial to assess the safety and efficacy of Venetoclax in addition to sequential conditioning with Fludarabine / Amsacrine / Ara-C (FLAMSA) + Treosulfan for allogeneic blood stem cell transplantation in patients with MDS, CMML or sAML
Protocol code: FLAMSAClax
Sponsor: Heinrich-Heine-Universitaet Duesseldorf (Educational Institution). Phase: Phase I and Phase II (Integrated)- Other. Countries: Germany (ongoing, recruiting).
Therapeutic area(s): Diseases [C] - Hemic and Lymphatic Diseases [C15]
Gender: Female, Male. Age: 18-64 years, 65+ years. Enrolment: 38.
Status: Ongoing, recruiting. Start date (EU): 2023-05-26. Decision date: 2024-07-25. Results received: No. Last updated: 2026-05-06.

Condition(s): Patients with myelodysplastic syndrome (MDS), chronic myelomonocytic leukemia (CMML) or secondary acute myeloid leukemia (sAML) before stem cell transplantation
Product: TACROLIMUS, AMSACRINE, PEGFILGRASTIM, RASBURICASE, FILGRASTIM, FEBUXOSTAT, ANTITHYMOCYTE IMMUNOGLOBULIN (RABBIT), TREOSULFAN, MYCOPHENOLIC ACID, Venetoclax, FLUDARABINE, CYTARABINE, ALLOPURINOL

Primary endpoint: safety, defined as the maximal organ toxicity to each organ system according to CTC criteria as well as the number of AEs of grade III or greater until day +30 (± 3) after transplantation
Endpoint(s): safety, defined as the maximal organ toxicity to each organ system according to CTC criteria as well as the number of AEs of grade III or greater until day +100 (± 7) after transplantation, graft failure defined as no donor chimerism at day +30 (± 3) after transplantation, incidence, course und severity of aGvHD and cGvHD during the first 2 years after transplantation, incidence, course and severity of VOD, time (days from day 0) to hematopoietic reconstitution (ANC>500/µl, PLT>20000/µl and PLT>50000/µl), time (days from day 0) to transfusion independence, best disease response within the first 100 days (± 7) after transplantation (according to IWG-criteria for MDS and ELN-criteria for AML), disease response and donor chimerism at day +30 (± 3), +60 (± 7) and +100 (± 7) after transplantation (according to IWG-criteria for MDS and ELN-criteria for AML), time (days from day 0) to complete donor chimerism in blood and marrow, disappearance of molecular markers of disease (yes/no, time in days from day 0 ), event-free survival (EFS, death, relapse and disease progression will be recorded as event), cumulative incidence of relapse (CIR, disease progression and relapse will be recorded as event), overall survival (OS, death will be recorded as event)

Source: https://euclinicaltrials.eu/ctis-public/view/2024-514688-24-00